EU clinical trial 2023-507774-41-00: Study to evaluate the safety of MAQ-001 as monotherapy and combination therapy in patients with advanced cancers
Protocol code: MQ01
Sponsor: MabQuest Therapeutics S.A. (Pharmaceutical company). Phase: Human Pharmacology (Phase I)- First administration to humans. Countries: France (ongoing, recruiting).
Therapeutic area(s): Diseases [C] - Pathological Conditions, Signs and Symptoms [C23]
Gender: Female, Male. Age: 18-64 years, 65+ years. Enrolment: 30.
Status: Ongoing, recruiting. Start date (EU): 2024-05-29. Decision date: 2024-02-19. Results received: No. Last updated: 2026-03-18.
Decision dates by country: FR: 2024-05-14

Condition(s): Advanced cancer histologies for which immune checkpoint blockade is an approved treatment option, such as: Metastatic melanoma, Lung cancer, Renal Cell Carcinoma (RCC), Hodgkin’s lymphoma, Microsatellite Instability (MSI)-high colon cancer, Hepatocellular Carcinoma (HCC), and Gastric cancer.

Source: https://euclinicaltrials.eu/ctis-public/view/2023-507774-41-00